EU clinical trial 2024-512857-25-00: Bioequivalence of Tofacitinib 10 mg Film-Coated Tablets versus Xeljanz® 10 mg Film-Coated Tablets in Healthy Subjects Under Fed Conditions
Protocol code: BLCL-TOF-FDA-04
Sponsor: Bluepharma Industria Farmaceutica S.A. (Pharmaceutical company). Phase: Human Pharmacology (Phase I)- Bioequivalence Study. Countries: Portugal (ended).
Therapeutic area(s): Not possible to specify
Gender: Female, Male. Age: 18-64 years. Enrolment: 38.
Status: Ended. Start date (EU): 2024-05-21. End date (EU): 2024-06-17. Decision date: 2024-05-14. Results received: No. Last updated: 2024-07-15.

Condition(s): No medical condition.

Source: https://euclinicaltrials.eu/ctis-public/view/2024-512857-25-00